EU clinical trial 2023-508743-43-00: Early ablation of atrial fibrillation in patients with hypertrophic cardiomyopathy
Protocol code: FLC.IV/X/22
Sponsor: Narodowy Instytut Kardiologii Stefana Kardynala Wyszynskiego Panstwowy Instytut Badawczy (Hospital/Clinic/Other health care facility). Phase: Therapeutic use (Phase IV). Countries: Poland (ended).
Therapeutic area(s): Diseases [C] - Cardiovascular Diseases [C14]
Gender: Female, Male. Age: 18-64 years. Enrolment: 725.
Status: Ended. End date (EU): 2025-09-16. Decision date: 2024-03-04. Results received: No. Last updated: 2024-09-16.

Condition(s): Hypertrophic cardiomyopathy (HCM) is the most common genetically determined disease of the heart, characterized by a varied picture and clinical course. The first comprehensive clinical description of the disease comes from the 1960s. Currently, the disease is diagnosed on the basis of a phenotypic picture showing left ventricular hypertrophy, which cannot be explained by the increased hemodymamic overload only. Observed hypertrophy (up to 30 to 50 mm) in some cases presents smaller (from 13 to 7 / 70 14 mm among family members), what may sometimes require differentiation from hypertrophy secondary to arterial hypertension or the physiological athlete heart phenomenon. Epidemiological studies have shown the incidence of the disease 1 per 500 people in the general population, but taking into account the clinical and genetic diagnosis, the incidence may reach even 1 per 200. It can be estimated that in Poland about 100,000 people may be affected by HCM, and only a part of them is diagnosed, mostly using imaging methods. Worldwide, HCM is likely to affect around 20 million people, come across a wide range of ethnicities and races, and affects both genders equally. Hypertrophic cardiomyopathy is an inherited disease in an autosomal dominant manner and is most often associated with mutations in one of described several genes coding for sarcomere proteins. Atrial fibrillation (AF) occurs in 20-25% of patients with hypertrophic cardiomyopathy, and the annual incidence of AF in HCM ranges from 2% to 3%. the reference center was 25.5%. The incidence of AF in patients with hypertrophic cardiomyopathy under 65 years of age in own data of the National Institute of Cardiology, was found to be as high as 25.5%. In elderly population, AF occurence is even higher, with respect to the high frequency and importance of this clinical problem for highly specialized centers. Due to the development of technologies for continuous ECG monitoring and the resulting changes in the sensitivity and specificity of AF diagnosis, the real AF occurrence in the population with HCM may be as high as 40-50%. At the same time, current studies indicate that AF significantly affects the prognosis of patients with HCM and the occurrence of any form of AF is associated with a significantly increased risk of systemic embolism (including CNS stroke) [relative risk (RR) 7.0; 95% CI 4.6-10.7], heart failure progression (RR 2.8; 95% CI 1.6-4.6), sudden cardiac death (RR 1.7; 95% CI 1.3-2 , 3) and all-cause mortality (RR 2.5; 95% CI 1.8-3.4) with a mean follow-up of 7 years. Hence, preventing the development of AF in patients with HCM seems to be an important therapeutic goal in this group. According to the recommendations of the Cardiac Societies worldwide, percutaneous ablation of AF can be considered in patients without significant left atrial enlargement, who have symptoms despite treatment, or who cannot take antiarrhythmic drugs or is a preferential choice. Currently, there are no prospective randomized trials of antiarrhythmic drugs versus ablation, what seems a significant limitation of all publications and recommendations regarding the treatment of AF in patients with HCM. The best and robust available registry data indicate that the initial attempt to maintain sinus rhythm with lifestyle modification and antiarrhythmic drugs is moderately successful and indicate potentially significant ablation efficacy; especially in the early stage of AF development in patients with HCM. The rationale we present led to the design of the submitted study.
Product: Bisocard, 2,5 mg, tabletki powlekane, Bisocard, 5 mg, tabletki powlekane, Cordarone 200 mg tablete, Betaloc ZOK 100, 95 mg, tabletki o przedłużonym uwalnianiu, Betaloc ZOK 50 mg tablety s prodlouženým uvolnováním, Opacorden, 200 mg, tabletki powlekane, SotaHEXAL 80 mg Tabletten, SotaHEXAL 160 mg Tabletten, Bisocard, 10 mg, tabletki powlekane

Primary endpoint: 1. death or 2. stroke / TIA or 3. extra-scheduled medical intervention defined as: hospitalization / emergency room / emergency room visit / medical visit
Endpoint(s): 1. atrial fibrillation load> 12 hours during any observation day, 2. mean fibrillation load during the follow-up period, 4. occurrence of silent AF in the HCM patient population, 5. occurrence of ventricular arrhythmias, including non-sustained ventricular tachycardia, 6. new ischemic changes in CNS MRI, 7. correlation of changes in MRI of the CNS with the AF burden, and: 8. change in quality of life assessed by the SF-36 questionnaire before and after one year after randomization.

Source: https://euclinicaltrials.eu/ctis-public/view/2023-508743-43-00